EU clinical trial 2022-502450-13-00: Open-label safety study in adults and adolescents with haemophilia A with and without FVIII inhibitors switching directly from emicizumab prophylaxis to NNC0365-3769 (Mim8) prophylaxis.
Protocol code: NN7769-4728
Sponsor: Novo Nordisk A/S (Pharmaceutical company). Phase: Therapeutic confirmatory (Phase III). Countries: Belgium (ended), Spain (ended), France (ended), Austria (ended), Italy (ended), Germany (ended).
Therapeutic area(s): Diseases [C] - Congenital, Hereditary, and Neonatal Diseases and Abnormalities [C16]
Gender: Female, Male. Age: 0-17 years, 18-64 years, 65+ years. Enrolment: 24.
Status: Ended. Start date (EU): 2023-07-21. End date (EU): 2024-06-17. End date: 2024-07-20. Decision date: 2023-06-20. Results received: Yes. Last updated: 2025-11-17.
Decision dates by country: ES: 2023-06-22, DE: 2023-06-26, BE: 2023-06-20, IT: 2023-06-23, FR: 2023-06-26, AT: 2023-06-26

Condition(s): Haemophilia A with or without coagulation factor VIII (FVIII) inhibitors.
Product: denecimig, denecimig, denecimig, denecimig

Primary endpoint: Number of treatment-emergent adverse events (TEAEs).
Endpoint(s): Device handling experience using haemophilia device assessment tool (H-DAT) questionnaire., Change in participants’ treatment burden using the haemophilia treatment experience measure (Hemo-TEM) total score.

Source: https://euclinicaltrials.eu/ctis-public/view/2022-502450-13-00